EU clinical trial 2024-516281-11-00: A Biomarker-Directed Phase 2 Trial of SY-1425, a Selective Retinoic Acid Receptor Alpha Agonist, in Adult Patients with Acute Myeloid Leukemia (AML) or Myelodysplastic Syndrome (MDS)
Protocol code: SY-1425-201
Sponsor: Syros Pharmaceuticals Inc. (Pharmaceutical company). Phase: Therapeutic exploratory (Phase II). Countries: France (ended).
Therapeutic area(s): Diseases [C] - Neoplasms [C04]
Gender: Female, Male. Age: 18-64 years, 65+ years. Enrolment: 1.
Status: Ended. Start date (EU): 2018-06-06. End date (EU): 2024-11-21. Decision date: 2024-09-05. Results received: No. Last updated: 2024-09-05.

Condition(s): Acute Myeloid Leukemia (AML) Myelodysplastic Syndrome (MDS)
Product: SY-1425, AZACITIDINE

Primary endpoint: ORR for biomarker positive patients with AML or higher-risk MDS (Arms 1, 2A, 2B, 5), TIR for patients with lower-risk MDS (Arm 3), Safety and tolerability of SY-1425 in combination with daratumumab assessed by the type and frequency of AEs and SAEs using National Cancer Institute (NCI) Common Terminology Criteria for Adverse Events (CTCAE) v 4.03, as well as changes in clinically significant clinical laboratory values, electrocardiogram (ECG) parameters and vital sign measurement (Arm 4)
Endpoint(s): ORR for AML or higher-risk MDS patients positive for the RARA super-enhancer associated biomarker (Arms 1, 2A, 2B, and 5), TIR for lower-risk MDS patients positive for the RARA super-enhancer associated biomarker (Arm 3), Response rate (ORR + TIR) for patients positive for the IRF8 biomarker and negative for the RARA super-enhancer associated biomarker treated with SY-1425 as a single agent (Arms 1, 2A, and 3), ORR for AML or higher-risk MDS patients positive for the IRF8 biomarker and negative for the RARA super-enhancer associated biomarker (Arms 1, 2A, 2B, and 5), TIR for lower-risk MDS patients positive for the IRF8 biomarker and negative for the RARA super-enhancer associated biomarker (Arm 3), ORR for AML patients who are treated with SY-1425 in combination with azacitidine (Arm 2B), ORR for AML or higher-risk MDS patients treated with SY-1425 in combination with daratumumab (Arm 4), Clinical activity as measured by EFS, RFS, DOR, OS, and HI in Arms 1, 2A, 2B, 4, and 5, Clinical activity as measured by DOR and HI in Arm 3, Proportion of patients requiring supportive measures secondary to cytopenias, as measured by changes in transfusion rates, incidence and duration of growth factor support and antibiotics use, and number of hospitalizations associated with febrile neutropenia and/or thrombocytopenic bleeding, Characterize the safety and tolerability of SY-1425 as a single agent and in combination with azacitidine by assessing the type and frequency of AEs and SAEs using National Cancer Institute (NCI) Common Terminology Criteria for Adverse Events (CTCAE) v 4.03, as well as changes in clinically significant clinical laboratory values, electrocardiogram (ECG) parameters and vital sign measurements (Arms 1, 2A, 2B, 3, and 5), PK parameters of SY-1425, as single agent and in combination with azacitidine or daratumumab, after single and multiple doses by performing PK analysis to define time to maximum concentration (tmax), Cmax, minimum plasma concentration (Cmin), AUC, total body clearance (CL/F) and half-life (t1/2), where the data permits

Source: https://euclinicaltrials.eu/ctis-public/view/2024-516281-11-00